EU clinical trial 2025-520715-13-00: A Phase 2, Randomized, Double-Blind, Placebo-Controlled Study of the Safety, Tolerability and Efficacy of Caveolin-1-Scaffolding-Protein-Derived Peptide (LTI-03) in Patients with Idiopathic Pulmonary Fibrosis (RENEW)
Protocol code: LTI-03-2001 (RENEW)
Sponsor: Rein Therapeutics Inc. (Pharmaceutical company). Phase: Therapeutic exploratory (Phase II). Countries: Germany (ongoing, recruiting), Poland (ongoing, recruiting).
Therapeutic area(s): Diseases [C] - Cardiovascular Diseases [C14]
Gender: Female, Male. Age: 18-64 years, 65+ years. Enrolment: 28.
Status: Ongoing, recruiting. Start date (EU): 2026-04-22. Decision date: 2025-10-06. Results received: No. Last updated: 2026-08-07.
Decision dates by country: PL: 2025-10-06, DE: 2025-10-06

Condition(s): Idiopathic Pulmonary Fibrosis
Product: The placebo is InhaLac® 500 (micronized lactose monohyrdate)., LTI-03

Primary endpoint: The incidence of treatment-emergent adverse events (TEAEs) from Day 1 through Week 24.
Endpoint(s): Change from baseline through 24 weeks in forced vital capacity (FVC) in mL., Change from baseline through 24 weeks in percent predicted forced vital capacity (ppFVC)., Change from baseline at 24 weeks in lung fibrosis measured by high resolution computed tomography (HRCT)., Exploratory Endpoint: Change from baseline through 24 weeks in the Living with Pulmonary Fibrosis (L-PF) questionnaire dyspnea and cough domains., Exploratory Endpoint: Time to all-cause respiratory hospitalization lung transplantation, or death through 28 weeks., Exploratory Endpoint: Change from baseline through 24 weeks for biomarkers related to the pathophysiology of IPF.

Source: https://euclinicaltrials.eu/ctis-public/view/2025-520715-13-00